EU clinical trial 2024-514905-79-00: An open-label phase 1b/2 study assessing the safety and efficacy of mitazalimab in combination with chemotherapy in patients with metastatic pancreatic ductal adenocarcinoma
Protocol code: A-20-1013-C-03
Sponsor: Alligator Bioscience AB (Pharmaceutical company). Phase: Phase I and Phase II (Integrated)- Other. Countries: France (ongoing, recruitment ended), Belgium (ongoing, recruitment ended), Spain (ongoing, recruitment ended).
Therapeutic area(s): Diseases [C] - Neoplasms [C04]
Gender: Female, Male. Age: 18-64 years, 65+ years. Enrolment: 94.
Status: Ongoing, recruitment ended. Start date (EU): 2021-09-17. Decision date: 2024-10-04. Results received: No. Last updated: 2025-07-02.
Decision dates by country: BE: 2024-10-07, FR: 2024-10-17, ES: 2024-10-04

Condition(s): Metastatic pancreatic ductal adenocarcinoma
Product: CALCIUM LEVOFOLINATE, IRINOTECAN, CALCIUM FOLINATE, IRINOTECAN, PACLITAXEL, GEMCITABINE, SODIUM FOLINATE, OXALIPLATIN, SODIUM LEVOFOLINATE, FLUOROURACIL

Primary endpoint: Part 1: Incidence of DLTs, Part 2 and Part 3: Objective response rate (ORR).
Endpoint(s): Best Overall Response (BOR), with response categories CR, PR, SD, and PD, Duration of response (DoR), Duration of SD, Disease control rate, Time to next anti-cancer therapy, Progression-free survival (PFS), Overall survival (OS), Type, frequency and severity of AEs, Detection and characterization of anti-drug antibody (ADA) titers in serum, PK parameters will include Cmax, Tmax, and AUC(0-T). Additional parameters may be calculated depending on data obtained, Part 1: Objective response rate (ORR)

Source: https://euclinicaltrials.eu/ctis-public/view/2024-514905-79-00